EU clinical trial 2026-525549-60-00: A study in healthy men to find out how blocking certain transport proteins affects the amount of BI 3000202 in the blood
Protocol code: 1509-0017
Sponsor: Boehringer Ingelheim International GmbH (Pharmaceutical company). Phase: Human Pharmacology (Phase I)- Other. Countries: Germany (authorised, recruitment pending).
Therapeutic area(s): Not possible to specify
Gender: Male. Age: 18-64 years. Enrolment: 16.
Status: Authorised, recruitment pending. Decision date: 2026-07-01. Results received: No. Last updated: 2026-07-01.

Condition(s): Healthy

Source: https://euclinicaltrials.eu/ctis-public/view/2026-525549-60-00